EU clinical trial 2024-518002-41-00: SAFIR02-Breast: Evaluation of the efficacy of high throughput genome analysis as a therapeutic decision tool for patients with metastatic breast cancer
Protocol code: UC 0105/01304
Sponsor: Unicancer (Hospital/Clinic/Other health care facility). Phase: Therapeutic exploratory (Phase II). Countries: France (ongoing, recruiting).
Therapeutic area(s): Diseases [C] - Neoplasms [C04]
Gender: Female. Age: 18-64 years, 65+ years. Enrolment: 1462.
Status: Ongoing, recruiting. Start date (EU): 2014-04-07. Decision date: 2024-10-16. Results received: No. Last updated: 2024-10-16.

Condition(s): Patients with metastatic breast cancer in 1st or 2nd line of chemotherapy
Product: IMFINZI 50 mg/mL concentrate for solution for infusion.

Primary endpoint: Progression-free survival (PFS) is defined as the time from randomization to the first documented progression of disease or death, whatever the cause. The tumor assessments are made by the investigators based on RECIST 1.1 criteria ([Eisenhauer 2009]). Patients still alive at the time of analysis without documented progression (including lost to follow-up) will be censored at the last known alive date.
Endpoint(s): Overall Survival (OS) is defined as the time from randomization to death due to any cause. Patients still alive at the time of analysis (including lost to follow-up) will be censored at the last known alive date., Objective response (i.e. complete or partial response) will be defined using RECIST V1.1 criteria. Changes in tumor size over time will also be analysed, Evaluation of safety will be done according to NCI CTCAE v4.03 criteria

Source: https://euclinicaltrials.eu/ctis-public/view/2024-518002-41-00